EU clinical trial 2024-519081-49-00: A multicenter, randomized, double-blind, placebo-controlled, Phase II platform study to assess the efficacy and safety of investigational compound(s) in patients with moderate to severe atopic dermatitis
Protocol code: CADPT17A12201
Sponsor: Novartis Pharma AG (Pharmaceutical company). Phase: Therapeutic exploratory (Phase II). Countries: Czechia (ongoing, recruiting), Netherlands (ongoing, recruiting), Poland (ongoing, recruiting), Germany (ongoing, recruiting), Spain (ongoing, recruiting), Hungary (ongoing, recruiting), France (ongoing, recruiting), Italy (ongoing, recruiting), Slovakia (ongoing, recruiting).
Therapeutic area(s): Diseases [C] - Skin and Connective Tissue Diseases [C17]
Gender: Female, Male. Age: 18-64 years, 65+ years. Enrolment: 104.
Status: Ongoing, recruiting. Start date (EU): 2025-10-28. Decision date: 2025-09-22. Results received: No. Last updated: 2026-08-05.
Decision dates by country: DE: 2025-09-24, HU: 2025-09-23, IT: 2025-09-24, ES: 2025-09-24, CZ: 2025-09-24, FR: 2025-09-23, NL: 2025-09-23, PL: 2025-09-24, SK: 2025-09-22

Condition(s): Moderate to severe atopic dermatitis
Product: Placebo to GHZ339, PIMECROLIMUS, GHZ339, TACROLIMUS

Primary endpoint: Percentage change from baseline in the EASI score at Week 16
Endpoint(s): IGA response at Week 16: IGA score of 0 (clear) or 1 (almost clear) and at least 2 points reduction from baseline IGA response at Week 16, EASI-75 response at Week 16: ≥75% reduction (improvement) from baseline in EASI score response at Week 16, Treatment emergent adverse events, vital signs, ECG, and laboratory assessments

Source: https://euclinicaltrials.eu/ctis-public/view/2024-519081-49-00